EU clinical trial 2023-503220-76-01: Prednisolone administration in women with unexplained REcurrent MIscarriages
Protocol code: LUMC-PREMI
Sponsor: Leiden University Medical Center (Hospital/Clinic/Other health care facility). Phase: Therapeutic use (Phase IV). Countries: Netherlands (ongoing, recruiting).
Therapeutic area(s): Diseases [C] - Female Urogenital Diseases and Pregnancy Complications [C13]
Gender: Female. Age: 18-64 years. Enrolment: 490.
Status: Ongoing, recruiting. Start date (EU): 2024-02-13. Decision date: 2023-10-05. Results received: No. Last updated: 2024-11-05.

Condition(s): Unexplained recurrent miscarriages
Product: Placebo tablet (per tablet); Base granulate(3), In-house, Biding/filling agent 152 mg Talc 0 H2O (heated) (4), Ph. Eur. /In-house, Glidant, 6.4 mg Magnesium stearate, Ph. Eur., Lubricant, 1.6 mg; 3 Base granulate is an in-house granulate made for tablets with the following composition (5 kg): 4 kg of Lactose (100 M) 1 H2O, 1 kg of Potato starch 0 H2O and approximately 720 ml gelatine spirit. 4 Talc is heated for 30 minutes at 250°C, to destroy spores of clostridium tetani. After heating talc is not additionally analysed., PREDNISOLONE, PREDNISOLONE

Primary endpoint: Last study subject has completed last visit and all data is gathered
Endpoint(s): DSMB advises to stop trial (for feasibility, slow inclusion rate, safety concerns etc.)

Source: https://euclinicaltrials.eu/ctis-public/view/2023-503220-76-01